EU clinical trial 2024-520264-33-00: Randomized phase III trial of sequential Re-Radiochemotherapy and Pembrolizumab versus Immuno(chemo)therapy for locoregionally recurrent PD-L1 positive HNSCC (CPS≥1)
Protocol code: RePaIr-HN
Sponsor: Universitaet Des Saarlandes (Educational Institution). Phase: Therapeutic confirmatory (Phase III). Countries: Germany (ongoing, recruiting).
Therapeutic area(s): Diseases [C] - Neoplasms [C04]
Gender: Female, Male. Age: 18-64 years, 65+ years. Enrolment: 204.
Status: Ongoing, recruiting. Start date (EU): 2025-10-07. Decision date: 2025-05-23. Results received: No. Last updated: 2026-04-02.

Condition(s): Locoregionally recurrent head and neck squamous cell carcinoma (HNSCC)
Product: FLUOROURACIL, CARBOPLATIN, PEMBROLIZUMAB, CISPLATIN

Primary endpoint: The primary endpoint of the trial is overall survival (OS). OS is defined as the time from the date of randomization to the date of death for any cause.
Endpoint(s): Progression-free survival (PFS), Locoregional tumor control, Location of locoregional tumor progression (in-field, out-of-field), Distant tumor control, Tumor related death, Response rate according to RECIST 1.1 criteria, Acute and late toxicity according to CTCAE version 5.0, Assessment of the patients tumor symptom burden (questionnaire), Assessment of swallowing function (EAT-10), Assessment of quality of life (EORTC QLQ-C30 and H&N-35)

Source: https://euclinicaltrials.eu/ctis-public/view/2024-520264-33-00